EU clinical trial 2024-519995-20-00: MECHANISMS OF NEURONAL RESILIENCE IN ALZHEIMER'S DISEASE AND ITS FOCAL VARIANTS: A MRI/PET STUDY
Protocol code: C19-40
Sponsor: Institut National De La Sante Et De La Recherche Medicale (Laboratory/Research/Testing facility). Phase: Phase II and Phase III (Integrated). Countries: France (authorised, recruitment pending).
Therapeutic area(s): Analytical, Diagnostic and Therapeutic Techniques and Equipment [E] - Diagnosis [E01]; Diseases [C] - Nervous System Diseases [C10]
Gender: Female, Male. Age: 18-64 years, 65+ years. Enrolment: 45.
Status: Authorised, recruitment pending. Decision date: 2025-01-29. Results received: No. Last updated: 2026-07-24.

Condition(s): Alzheimer's pathology, Maladie d' Alzheimer
Product: 18F-AV-1451

Primary endpoint: 1) The topographic distribution regions of tau lesions, thanks to PET brain imaging using the 18F-AV-1451 as a ligand. 2) The correlation between the distribution of these tau lesions and: the cortical volume, the indices of integrity of the white matter bundles, the functional neural networks, as well as the reorganization of the "hubs" of these networks, thanks to the structural MRI, diffusion (MRI) and functional at rest (fMRI) imaging
Endpoint(s): Correlation between the concentration of tau and tau-phosphorylated proteins in cerebrospinal fluid (CSF) with the severity of hypometabolism measured by tau-PET. To establish this correlation the evaluation criterion is represented on one side by the cortico-cerebellar indices of fixation of the tau protein radioligand in PET, on the other side by the concentration of tau proteins in the CSF and tau-phosphorylated. Correlation between anatomical and functional connectivity.

Source: https://euclinicaltrials.eu/ctis-public/view/2024-519995-20-00